EU clinical trial 2024-514491-40-00: [18F]fluor-PEG-folate PET/CT imaging in giant cell arteritis: a pilot study
Sponsor: Universitair Medisch Centrum Groningen (Hospital/Clinic/Other health care facility). Phase: Therapeutic exploratory (Phase II). Countries: Netherlands (ongoing, recruiting).
Therapeutic area(s): Diseases [C] - Cardiovascular Diseases [C14]
Gender: Female, Male. Age: 18-64 years, 65+ years. Enrolment: 10.
Status: Ongoing, recruiting. Start date (EU): 2024-11-12. Decision date: 2024-09-11. Results received: No. Last updated: 2024-09-11.

Condition(s): giant cell arteritis
Product: [18F]Fluor-PEG-Folate

Primary endpoint: Arterial [18F]fluor-PEG-folate uptake on PET/CT in patients with active, large vessel GCA; and in the same patients after 9 months of standard treatment.

Source: https://euclinicaltrials.eu/ctis-public/view/2024-514491-40-00